EU clinical trial 2024-519975-24-00: Dendritic cells therapy combined with immunomodulatory treatment in multiple sclerosis
Protocol code: TolDec-COMBINEM
Sponsor: Fundacio De Recerca Clinic Barcelona-Institut D’Investigacions Biomediques August Pi I Sunyer (Laboratory/Research/Testing facility). Phase: Therapeutic exploratory (Phase II). Countries: Spain (ended).
Therapeutic area(s): Diseases [C] - Nervous System Diseases [C10]
Gender: Female, Male. Age: 18-64 years. Enrolment: 45.
Status: Ended. Start date (EU): 2025-01-13. End date (EU): 2026-03-03. Decision date: 2025-01-13. Results received: No. Last updated: 2025-01-13.

Condition(s): Multiple sclerosis
Product: TolDec

Primary endpoint: EFFICACY - Changes from baseline in the number of CUA lesion (mean number of the sum at week 12, 18 and 24). A CUA lesion is defined as a new or persisting gadolinium-enhancing (Gd+) lesion on T1 MRI or a new or enlarging lesion on T2. Lesions identified in both scans were only counted once., SAFETY: - Proportion of patients with any Grade 3 -4 adverse events related to product administration during the study period. - Proportion of patients with any Grade 3 -4 adverse events related to study product.

Source: https://euclinicaltrials.eu/ctis-public/view/2024-519975-24-00